EU clinical trial 2025-524889-25-00: Preventive effect of 5% lidocaine patch on the development of neuropathic pain following an osteoporotic vertebral fracture: A proof-of-concept, controlled, randomized trial
Protocol code: FLYNN
Sponsor: University Hospital Of Clermont-Ferrand (Hospital/Clinic/Other health care facility). Phase: Therapeutic exploratory (Phase II). Countries: France (authorised, recruiting).
Therapeutic area(s): Diseases [C] - Musculoskeletal Diseases [C05]
Gender: Female, Male. Age: 18-64 years, 65+ years. Enrolment: 30.
Status: Authorised, recruiting. Start date (EU): 2026-07-27. Decision date: 2026-06-17. Results received: No. Last updated: 2026-06-17.

Condition(s): Osteoporotic Fracture
Product: VERSATIS 700 mg, emplâtre médicamenteux

Primary endpoint: Onset of neuropathic pain 2 months after enrollment, as a percentage of patients, using the Pain Detect Questionnaire (score ≥19).
Endpoint(s): Adverse effects and compliance in the daily logbook, Pain assessment (numerical scale) after 2 months of treatment, Concomitant treatments, Quality of life of patients according to SF36 and sleep according to PSQI, Psychophysical assessment in neuropathic patients

Source: https://euclinicaltrials.eu/ctis-public/view/2025-524889-25-00